EU clinical trial 2022-502160-20-00: A multicenter, randomized, double-blind, parallel group, placebo-controlled study to evaluate the efficacy and safety of iptacopan (LNP023) in idiopathic immune complex mediated membranoproliferative glomerulonephritis (IC-MPGN)
Protocol code: CLNP023B12302
Sponsor: Novartis Pharma AG (Pharmaceutical company). Phase: Therapeutic confirmatory (Phase III). Countries: France (ongoing, recruiting), Spain (ongoing, recruiting), Czechia (ongoing, recruiting), Germany (ongoing, recruiting), Italy (ongoing, recruiting), Poland (ongoing, recruiting), Greece (ongoing, recruiting), Slovakia (authorised, recruitment pending), Netherlands (ongoing, recruiting), Denmark (ongoing, recruiting).
Therapeutic area(s): Diseases [C] - Immune System Diseases [C20]
Gender: Female, Male. Age: 0-17 years, 18-64 years. Enrolment: 39.
Start date (EU): 2023-10-02. Decision date: 2023-09-13. Results received: No. Last updated: 2026-07-31.
Decision dates by country: GR: 2025-07-17, DE: 2023-09-14, DK: 2025-12-05, PL: 2023-09-18, CZ: 2023-09-13, NL: 2025-10-16, SK: 2025-07-28, IT: 2023-09-18, ES: 2023-09-13, FR: 2023-11-23

Condition(s): Idiopathic Immune Complex Mediated Membranoproliferative Glomerulonephritis (IC-MPGN)
Product: IPTACOPAN HYDROCHLORIDE, Placebo 0 mg hard gelatin capsule size 1, (placebo to LNP023 100 mg), Placebo 0 mg hard gelatin capsule size 0, (placebo to LNP023 200 mg), IPTACOPAN

Primary endpoint: Log-transformed ratio to baseline in UPCR (sampled from a 24-hour urine collection) at 6 months.
Endpoint(s): Change from baseline in eGFR at 12 months. Annualized total eGFR slope estimated over 12 months., Log-transformed ratio to baseline in UPCR (sampled from a 24-hour urine collection) at 12 months., Change from baseline to 12 months in the Functional Assessment of chronic Illness Therapy-Fatigue (FACIT-Fatigue) score., Occurrence of clinically significant vital signs (mean sitting diastolic blood pressure [msSBP], heart rate, electrocardiograms (ECG), and safety laboratory measurements, as well as adverse events (AEs), AEs of special interest, and study drug discontinuation due to an AE (or any safety issue) during the double-blind period of the study., Additional cardiovascular safety surveillance-performed only in adolescent patients includes the evaluation of iptacopan’s potential effects on heart rate, systolic and diastolic blood pressures, cardiac function, and a cardiac biomarker throughout the double-blind and open label treatment periods., Proportion of participants who achieved the composite renal endpoint at 6 months, Proportion of participants who achieved the composite renal endpoint at 12 months.

Source: https://euclinicaltrials.eu/ctis-public/view/2022-502160-20-00